EU clinical trial 2023-506503-26-00: A Phase 3, double-blind, placebo-controlled study evaluating efficacy and safety of riliprubart in participants with refractory chronic inflammatory demyelinating polyneuropathy
Protocol code: EFC17236
Sponsor: Sanofi-Aventis Recherche & Developpement (Pharmaceutical company). Phase: Therapeutic confirmatory (Phase III). Countries: Italy (ongoing, recruitment ended), Spain (ongoing, recruitment ended), Denmark (ongoing, recruitment ended), Bulgaria (ongoing, recruitment ended), Czechia (ended), Greece (ongoing, recruitment ended), Belgium (ongoing, recruitment ended), Sweden (ongoing, recruitment ended), Netherlands (ongoing, recruitment ended), Poland (ongoing, recruitment ended), France (ongoing, recruitment ended), Portugal (ongoing, recruitment ended), Germany (ongoing, recruitment ended).
Therapeutic area(s): Diseases [C] - Immune System Diseases [C20]
Gender: Female, Male. Age: 18-64 years, 65+ years. Enrolment: 82.
Start date (EU): 2024-07-31. Decision date: 2024-06-17. Results received: No. Last updated: 2026-08-03.
Decision dates by country: BG: 2024-06-24, DK: 2024-06-18, BE: 2024-06-18, SE: 2024-06-19, PL: 2024-06-24, FR: 2024-06-19, GR: 2024-08-20, CZ: 2024-06-20, ES: 2024-06-17, NL: 2024-06-20, IT: 2024-06-18, PT: 2024-06-19, DE: 2024-08-22

Condition(s): Polyneuropathy, Inflammatory Demyelinating, Chronic
Product: riliprubart placebo, solution for injection in prefilled pen (PFP), riliprubart placebo, solution for injection in vial, riliprubart, riliprubart

Primary endpoint: Percentage of participants experiencing a response, Percentage of participants randomized to riliprubart with lasting response, Percentage of participants randomized to placebo who experience a response
Endpoint(s): Change from baseline in Inflammatory Rasch-built Overall Disability Scale (I-RODS) score, Change from baseline in adjusted inflammatory neuropathy cause and treatment (INCAT) disability score, Change from baseline in grip strength (kilopascals; dominant hand), Change from baseline in Medical Research Council Sum Score (MRC-SS), Percentage of participants refractory to immunoglobulins experiencing a response, Change from baseline in the EuroQol 5 Dimension, 5-Level Health Scale (EQ-5D-5L), Change from baseline in the Rasch-built modified fatigue severity scale (RT-FSS), Number of participants with treatment-emergent adverse events (TEAEs), including serious adverse events (SAEs) and adverse events of special interest (AESIs) for Part A, Incidence and titer of anti-riliprubart antibodies (ADA), Number of participants with TEAEs, including Serious Adverse Events (SAEs) and Adverse Events of Special Interest (AESIs) for Part B, Incidence and titer of anti-riliprubart antibodies, Change from baseline in I-RODS score, Change from baseline in adjusted INCAT score, Change from baseline in grip strength (kilopascals; dominant hand), Change from baseline in MRC-SS, Change from baseline in EQ-5D-5L score, Change from baseline in RT-FSS, Percentage of participants randomized to riliprubart who experience a response at Week 48 without prior response in Part A (delayed response)

Source: https://euclinicaltrials.eu/ctis-public/view/2023-506503-26-00